EU clinical trial 2024-516371-32-00: CombiChronoS - Effectiveness of a Combination of Chronotherapeutics for the Treatment of Major Depressive Episode (MDE) with Insomnia: A Multicenter, Randomized, Double-Blind, Placebo-Controlled 2x2 Factorial Trial
Protocol code: APHP230869
Sponsor: Assistance Publique Hopitaux De Paris (Hospital/Clinic/Other health care facility). Phase: Therapeutic confirmatory (Phase III). Countries: France (ongoing, recruiting).
Therapeutic area(s): Psychiatry and Psychology [F] - Mental Disorders [F03]
Gender: Female, Male. Age: 18-64 years. Enrolment: 184.
Status: Ongoing, recruiting. Start date (EU): 2026-01-28. Decision date: 2025-05-12. Results received: No. Last updated: 2025-05-12.

Condition(s): insomnia, Depressive episode
Product: MELATONINE ARROW LP 2 mg, comprimé à libération prolongée, PLACEBO DE MELATONINE ARROW LP 2 mg comprimé

Primary endpoint: Montgomery-Åsberg Depression Rating Scale (MADRS) score at 8 weeks (Week 8, Visit 3 – clinical evaluation visit) adjusted for the baseline score (Week 0, Visit 0 – inclusion and randomization visit) in each of the four treatment arms
Endpoint(s): 1. MADRS score at 1, 4, 8 weeks, and 3 months: o Therapeutic response (50% reduction in MADRS score). o Remission (MADRS score ≤ 10)., 2. Subjective sleep quality at 1, 4, 8 weeks, and 3 months: sleep and sleep-wake rhythm self-questionnaires, 3. Objective actigraphy parameters at 1, 4, and 8 weeks: o Sleep parameters: total sleep time, nocturnal awakenings (WASO), fragmentation index, sleep efficiency (total sleep time/total time in bed), time spent in bed. o Rhythm parameters: relative amplitude, stability, and variability of sleep-wake rhythms, L5 and M10 phase markers (onset of the least active 5 hours and most active 10 hours)., 4. Subjective sleep diary parameters at 1, 4, and 8 weeks., 5. Slope of longitudinal evolution of the MADRS score, 6. Time (in days) to therapeutic response (maximum assessment at 3 months)., 7. Side effects questionnaire (PRISE-M) at 1, 4, and 8 weeks, 8. Mood state and overall functioning questionnaires (YMRS, C-SSRS, QIDS-SR, GAG7, CGI) at 1, 4, 8 weeks, and 3 months

Source: https://euclinicaltrials.eu/ctis-public/view/2024-516371-32-00